EU clinical trial 2024-515981-14-00: Pressurized intraperitoneal aerosol chemotherapy (PIPAC) in multimodal therapy for patients with oligometastatic peritoneal gastric cancer: a randomized multicenter phase III trial. PIPAC_VEROne
Protocol code: PIPAC_VEROne
Sponsor: Azienda Ospedaliera Universitaria Integrata Verona (Hospital/Clinic/Other health care facility). Phase: Therapeutic confirmatory (Phase III). Countries: Italy (ongoing, recruiting).
Therapeutic area(s): Diseases [C] - Digestive System Diseases [C06]
Gender: Female, Male. Age: 18-64 years, 65+ years. Enrolment: 98.
Status: Ongoing, recruiting. Start date (EU): 2022-12-14. Decision date: 2024-11-19. Results received: No. Last updated: 2024-11-19.

Condition(s): Gastric adenocarcinoma with peritoneal metastases
Product: FLUOROURACIL, DOCETAXEL, OPDIVO 10 mg/mL concentrate for solution for infusion., OXALIPLATIN, CALCIUM LEVOFOLINATE, CISPLATIN, DOXORUBICIN HYDROCHLORIDE

Primary endpoint: Secondary Resectability Rate (%) evaluated as the % of patients in the 2 arms who will go to CRS and HIPEC compared to the total number of participants at the end of 6 or 12 cycles of chemotherapy in the Arm A and at the end of the 6 cycles of chemotherapy and the 3 PIPACs in arm B; PFS at 1 and 3 years measured as time from randomization at the first evidence of progression (peritoneal or extraperitoneal) or death of patient for any cause, whichever comes first.
Endpoint(s): overall survival at 1 and 3 years, measured as survival time from randomization until death from any cause; this endpoint will be compared between the two treatment arms, DRS at 1 and 3 years measured as survival time from randomization until cancer-related death; this endpoint will be compared between the two treatment arms, For each patient in Arm B, starting from second cycle of PIPAC, a PRGS score will be assigned for each of the 4 biopsies performed, associated with an average PRGS score, given by the arithmetic mean of the individuals scores. In Arm A, this evaluation can only be carried out on the first occasion restaging after 3 months of treatment on biopsies performed during laparoscopy restaging or at the end of 6 months in those patients with stable disease who continued treatment chemotherapy, Degree of histological regression on the surgical specimen assessed using Tumor Regression Grade (TRG) sec. Mandard and compared between the two treatment arms in patients who will undergo cytoreduction and HIPEC, The quality of life QoL assessed using the validated EORTC QLQ C30 questionnaire, administered to the patient at the beginning of recruitment and after each treatment cycle or PIPAC and compared between the two treatment arms, Adverse events assessed by CTCAE v.5 after each treatment cycle and after each PIPAC and compared between the two treatment arms, Calculation of incremental cost-effectiveness ratios (Incremental Cost-Effectiveness Ratio= ICER) per additional resectable case and per year of life gained

Source: https://euclinicaltrials.eu/ctis-public/view/2024-515981-14-00